EU clinical trial 2025-524468-40-00: A multiCenter phase I study of aUtologous CD19 CAR T cElls for therapy refractory chronic GvHD (CURE-cGvHD)
Protocol code: CURE-cGvHD
Sponsor: Universitaetsklinikum Erlangen AöR (Hospital/Clinic/Other health care facility). Phase: Human Pharmacology (Phase I)- Other. Countries: Germany (authorised, recruiting).
Therapeutic area(s): Diseases [C] - Immune System Diseases [C20]
Gender: Female, Male. Age: 18-64 years, 65+ years. Enrolment: 14.
Status: Authorised, recruiting. Start date (EU): 2026-06-09. Decision date: 2026-03-27. Results received: No. Last updated: 2026-03-27.

Condition(s): chronic Graft-versus-Host-Disease (cGvHD)

Source: https://euclinicaltrials.eu/ctis-public/view/2025-524468-40-00